EU clinical trial 2024-518873-32-00: Administration of the BCL-2 antagonist, venetoclax, to promote apoptosis of HIV-infected cells and reduce the size of the HIV reservoir: An investigator-initiated phase I/IIb clinical trial in people living with HIV on antiretroviral therapy (The AMBER Study)
Protocol code: AMB-001
Sponsor: Region Midtjylland (Hospital/Clinic/Other health care facility). Phase: Phase I and Phase II (Integrated)- Other. Countries: Denmark (ongoing, recruiting).
Therapeutic area(s): Diseases [C] - Virus Diseases [C02]; Diseases [C] - Immune System Diseases [C20]
Gender: Female, Male. Age: 18-64 years. Enrolment: 27.
Status: Ongoing, recruiting. Start date (EU): 2022-10-28. Decision date: 2024-10-23. Results received: No. Last updated: 2026-01-29.

Condition(s): HIV-1 disease
Product: Venclyxto 100 mg film-coated tablets

Primary endpoint: Safety defined as treatment-emerging adverse events (AEs) >=grade 3 (as cited as dose limiting toxicities section 4.2) probably or definitely related to study treatment, Safety defined as all other treatment-emerging AEs, graded according to severity and assessed as either not related or possibly, probably or definitely related to study treatment

Source: https://euclinicaltrials.eu/ctis-public/view/2024-518873-32-00